EU clinical trial 2022-502802-34-00: A phase 3, prospective, open-label, multisite, extension of phase 3 studies to assess the long-term safety and tolerability of soticlestat as adjunctive therapy in subjects with Dravet Syndrome or Lennox-Gastaut Syndrome (ENDYMION 2)
Protocol code: TAK-935-3003
Sponsor: Takeda Development Center Americas Inc. (Pharmaceutical company). Phase: Therapeutic confirmatory (Phase III). Countries: Latvia (ended), Germany (ended), Netherlands (ended), France (ended), Spain (ended), Italy (ended), Hungary (ended), Belgium (ended), Poland (ended), Greece (ended).
Therapeutic area(s): Diseases [C] - Nervous System Diseases [C10]
Gender: Female, Male. Age: 0-17 years, 18-64 years. Enrolment: 127.
Status: Ended. Start date (EU): 2022-04-05. End date (EU): 2024-11-29. End date: 2025-09-24. Decision date: 2024-02-14. Results received: Yes. Last updated: 2025-06-03.
Decision dates by country: FR: 2024-03-07, PL: 2024-02-16, BE: 2024-02-16, GR: 2024-03-20, HU: 2024-02-14, IT: 2024-02-15, LV: 2024-02-14, ES: 2024-02-19, NL: 2024-02-27, DE: 2024-02-16

Condition(s): Dravet and Lennox-Gastaut Syndromes

Primary endpoint: 01. Incidence of TEAEs., 02. Incidence of abnormal values for clinical laboratory tests and electrocardiogram (ECG) evaluations., 03. Change from baseline in clinical laboratory test values, vital signs, Columbia-Suicide Severity Rating Scale (C-SSRS), and ECG parameters, 04. Change from baseline in height and weight for all age groups., 05. Absolute value for Tanner stage for children 6 to 17 years of age during the study, 06. Absolute values for IGF-1 for children 2 to 17 years of age during the study
Endpoint(s): 01. Percent change from baseline in total seizure frequency per 28 days for each (DS and LGS) cohort., 02. Percent change from baseline in convulsive seizure frequency (DS) per 28 days, 03. Percent change from baseline in MMD seizure frequency (LGS) per 28 days, 04. Effect on the CGI-I and Care GI-I., 05. Effect on CGI-I Seizure Intensity and Duration., 06. Effect on the CGI-I Nonseizure Symptoms completed by clinician with input from the caregivers., 07. Effect on QI-Disability.

Source: https://euclinicaltrials.eu/ctis-public/view/2022-502802-34-00